EU clinical trial 2023-504404-28-00: ASPIRE-1: Individual and combined endothelin receptor and SGLT2 antagonism in adults with type 1 diabetes mellitus and chronic kidney disease: a Phase 2, multicenter, open-label randomized cross-over trial
Protocol code: Protocol ID: 17042
Sponsor: University Medical Center Groningen (Hospital/Clinic/Other health care facility). Phase: Therapeutic exploratory (Phase II). Countries: Netherlands (not authorised), Finland (not authorised), Denmark (not authorised).
Therapeutic area(s): Diseases [C] - Nutritional and Metabolic Diseases [C18]
Gender: Female, Male. Age: 18-64 years. Enrolment: 36.
Status: Not authorised. Decision date: 2026-02-02. Results received: No. Last updated: 2026-02-09.
Decision dates by country: DK: 2026-02-03, FI: 2026-02-09, NL: 2026-02-02

Condition(s): Chronic Kidney Disease, Type 1 Diabetes
Product: Forxiga 5 mg film-coated tablets

Primary endpoint: Change from baseline in Urine Albumin-Creatinine Ratio (UACR) when treated with SC0062 alone versus combination of dapagliflozin and SC0062.
Endpoint(s): Change from baseline in markers of fluid retention (body weight, hemoglobin, N-terminal prohormone of Brain Natriuretic Peptide (NT-proBNP)), Extracellular Volume (ECV), blood pressure, and estimated glomerular filtration rate (eGFR)when treated with SC0062 or dapagliflozin alone versus combination of dapagliflozin and SC0062. Safety: To assess the incidence, severity and seriousness of adverse events during treatment with SC0062 and/or dapagliflozin.

Source: https://euclinicaltrials.eu/ctis-public/view/2023-504404-28-00